EU clinical trial 2024-512368-79-00: A Phase 2, Multicenter, Randomized, Open-label Study of Ifinatamab Deruxtecan (I DXd), a B7-H3 Antibody Drug Conjugate (ADC), in Subjects with Pretreated Extensive-stage Small Cell Lung Cancer (ES-SCLC) (IDeate Lung01)
Sponsor: Daiichi Sankyo Inc. (Pharmaceutical company). Phase: Therapeutic exploratory (Phase II). Countries: Spain (ongoing, recruitment ended), France (ongoing, recruitment ended), Germany (ongoing, recruitment ended).
Therapeutic area(s): Diseases [C] - Neoplasms [C04]
Gender: Female, Male. Age: 18-64 years, 65+ years. Enrolment: 49.
Status: Ongoing, recruitment ended. Start date (EU): 2022-10-10. Decision date: 2024-07-12. Results received: No. Last updated: 2026-06-05.
Decision dates by country: DE: 2024-07-15, ES: 2024-07-12, FR: 2024-07-15

Condition(s): Pretreated Extensive-stage Small Cell Lung Cancer (ES-SCLC)
Product: Ifinatamab deruxtecan

Primary endpoint: Objective response rate (ORR), defined as the proportion of subjects with a BOR of confirmed CR or confirmed PR assessed by blinded independent central review (BICR) based on RECIST v1.1.

Source: https://euclinicaltrials.eu/ctis-public/view/2024-512368-79-00